EU clinical trial 2023-509993-49-00: Nitrous oxide abuse in traffic – A clinical study of the blood concentrations and driving ability during and after short recreational intake.
Sponsor: Koebenhavns Universitet (Educational Institution). Phase: Therapeutic use (Phase IV). Countries: Denmark (ended).
Therapeutic area(s): Not possible to specify
Gender: Female, Male. Age: 18-64 years. Enrolment: 12.
Status: Ended. Start date (EU): 2024-05-19. End date (EU): 2025-02-21. Decision date: 2024-03-22. Results received: No. Last updated: 2024-05-23.

Condition(s): Recreational use while driving a vehicle. Healthy volunteers.
Product: Medicinsk Oxygen “Strandmøllen”, medicinsk gas, komprimeret, Kalinox, medicinsk gas, komprimeret

Primary endpoint: the blood concentration curve for nitrous oxide following the imitated recreational intake of nitrous oxide
Endpoint(s): the driving ability before, during and after imitated recreational intake of nitrous oxide, measured on a medium-fidelity driving simulator

Source: https://euclinicaltrials.eu/ctis-public/view/2023-509993-49-00